EU clinical trial 2024-514239-21-00: An Open Label, Single Cohort Study to Assess the Pharmacokinetic Profile of Nusinersen (BIIB058) Administered via the ThecaFlex DRx™ System (PIERRE-PK)
Protocol code: 295SM101
Sponsor: Biogen Idec Research Limited (Pharmaceutical company). Phase: Human Pharmacology (Phase I)- Other. Countries: Poland (authorised, recruitment pending), France (authorised, recruitment pending), Spain (ongoing, recruiting), Germany (authorised, recruitment pending), Italy (ended).
Therapeutic area(s): Diseases [C] - Musculoskeletal Diseases [C05]
Gender: Female, Male. Age: 0-17 years, 18-64 years, 65+ years. Enrolment: 26.
Start date (EU): 2025-05-21. Decision date: 2025-02-10. Results received: No. Last updated: 2026-05-29.
Decision dates by country: PL: 2025-02-13, FR: 2025-05-14, IT: 2025-02-10, ES: 2025-02-12, DE: 2025-03-20

Condition(s): Spinal Muscular Atrophy
Product: Spinraza 12 mg solution for injection

Primary endpoint: Maximum Observed Concentration (Cmax) of Nusinersen Delivered via Standard LP and via ThecaFlex DRx System., Area Under the Plasma Concentration-Time Curve From Zero Time to 24 Hours After Intrathecal Administration (AUC0-24h) of Nusinersen Delivered via Standard LP and via ThecaFlex DRx System

Source: https://euclinicaltrials.eu/ctis-public/view/2024-514239-21-00